EU clinical trial 2022-502499-22-00: A Phase 2a Study to Evaluate the Safety and Pharmacokinetics of Luspatercept (ACE-536) in Pediatric Participants with Beta (β) Thalassemia.
Protocol code: ACE-536-B-THAL-004
Sponsor: Celgene Corp. (Pharmaceutical company). Phase: Therapeutic exploratory (Phase II). Countries: Italy (ongoing, recruiting), Greece (ongoing, recruiting), Germany (ongoing, recruiting).
Therapeutic area(s): Diseases [C] - Congenital, Hereditary, and Neonatal Diseases and Abnormalities [C16]
Gender: Female, Male. Age: 0-17 years. Enrolment: 57.
Status: Ongoing, recruiting. Start date (EU): 2019-10-15. Decision date: 2023-07-07. Results received: No. Last updated: 2025-10-09.
Decision dates by country: GR: 2023-07-07, IT: 2023-07-11, DE: 2023-07-07

Condition(s): Beta (β) Thalassemia
Product: Reblozyl 25 mg powder for solution for injection, Reblozyl 75 mg powder for solution for injection

Primary endpoint: To determine the recommended dose (RD) for TD and NTD β-thalassemia participants, To evaluate the pharmacokinetics (PK) for TD and NTD β-thalassemia participants
Endpoint(s): • The safety for TD and NTD β-thalassemia participants including: Type,frequency, seriousness, and severity of AEs and relationship to luspatercept (per NCI CTCAE version 5.0), • The immunogenicity in TD andNTD β-thalassemiaparticipants, • The mean change in RBC transfusion burden in TDβ-thalassemia participants, • The mean change in hemoglobin levels in NTD β-thalassemia participants, • The mean change in mean daily dose of iron chelation therapy (ICT) in TD and NTD β-thalassemia participants, • The mean change in serum ferritin in TD andNTD β-thalassemia participants

Source: https://euclinicaltrials.eu/ctis-public/view/2022-502499-22-00